EU clinical trial 2024-514632-24-02: Optimisation of treatment in patients with CRSwNP. An RCT of mepolizumab and surgical treatment with FESS and mepolizumab versus only mepolizumab over a 6- and 12-month follow-up
Sponsor: Rigshospitalet (Hospital/Clinic/Other health care facility). Phase: Phase III and phase IV (Integrated). Countries: Denmark (ongoing, recruiting).
Therapeutic area(s): Diseases [C] - Respiratory Tract Diseases [C08]; Diseases [C] - Otorhinolaryngologic Diseases [C09]
Gender: Female, Male. Age: 18-64 years, 65+ years. Enrolment: 58.
Status: Ongoing, recruiting. Start date (EU): 2025-05-02. Decision date: 2024-08-30. Results received: No. Last updated: 2025-09-05.

Condition(s): Chronic Rhinosinusitis with Nasal Polyposis
Product: MEPOLIZUMAB

Primary endpoint: Change in SNOT-22 score, Nasal polyp score and smell

Source: https://euclinicaltrials.eu/ctis-public/view/2024-514632-24-02